EU clinical trial 2024-515926-10-00: An open-label, single-arm, multicenter, phase 3 study to assess pharmacokinetics, safety and tolerability of iptacopan in pediatric PNH patients aged 2 to <18 years of age
Protocol code: CLNP023I12201
Sponsor: Novartis Pharma AG (Pharmaceutical company). Phase: Therapeutic confirmatory (Phase III). Countries: Netherlands (authorised, recruitment pending), Germany (ongoing, recruiting), France (authorised, recruitment pending), Spain (authorised, recruitment pending), Italy (ongoing, recruiting).
Therapeutic area(s): Diseases [C] - Immune System Diseases [C20]
Gender: Female, Male. Age: 0-17 years. Enrolment: 5.
Start date (EU): 2025-10-28. Decision date: 2025-06-10. Results received: No. Last updated: 2026-03-17.
Decision dates by country: FR: 2025-06-11, IT: 2025-06-11, ES: 2025-06-11, DE: 2025-06-10, NL: 2025-06-11

Condition(s): Paroxysmal Nocturnal Hemoglobinuria (PNH)
Product: IPTACOPAN HYDROCHLORIDE

Primary endpoint: Safety evaluations, including AEs, SAEs, laboratory parameters, vital signs, and cardiovascular parameters., PK parameters Cmax, AUClast, AUCtau (and other PK parameters in plasma, as appropriate), and Ctrough concentrations.
Endpoint(s): Change in hemoglobin (Hb) from baseline ≥ 1 g/dL at Week 26 (in the absence of red blood cell (RBC) transfusions from Day 14). Change in Hb from baseline ≥ 1 g/dL at Week 52 (in the absence of RBC transfusions from Day 14). Change in Hb from baseline ≥ 2 g/dL at Week 26 (in the absence of RBC transfusions from Day 14). Change in Hb from baseline ≥ 2 g/dL at Week 52 (in the absence of RBC transfusions from Day 14)., Normal Hb at Weeks 26 in the absence of RBC transfusions from Day 14. Normal Hb at Week 52 in the absence of RBC transfusions from Day 14., Absence of packed-RBC transfusions and not meeting transfusion criteria from Day 14 at Week 26. Absence of packed-RBC transfusions and not meeting transfusion criteria from Day 14 at Week 52., Change from baseline in Hb and LDH at Week 26. Change from baseline in Hb and LDH at Week 52., Safety evaluations (including AEs, SAEs, lab parameters, vital signs, and cardiovascular parameters).

Source: https://euclinicaltrials.eu/ctis-public/view/2024-515926-10-00